EU clinical trial 2024-516260-29-00: THE (COST)EFFECTIVENESS OF NEOADJUVANT FOLFIRINOX VERSUS NEOADJUVANT GEMCITABINE BASED CHEMORADIOTHERAPY AND ADJUVANT GEMCITABINE FOR (BORDERLINE) RESECTABLE PANCREATIC CANCER (PREOPANC-2 STUDY)
Sponsor: Erasmus Universitair Medisch Centrum Rotterdam (Erasmus MC) (Hospital/Clinic/Other health care facility). Phase: Therapeutic confirmatory (Phase III). Countries: Netherlands (ended).
Therapeutic area(s): Diseases [C] - Neoplasms [C04]
Gender: Female, Male. Age: 18-64 years, 65+ years. Enrolment: 368.
Status: Ended. Start date (EU): 2024-10-10. End date (EU): 2025-09-10. Decision date: 2024-10-09. Results received: No. Last updated: 2024-10-09.

Condition(s): non-metastatic (borderline) resectable pancreatic cancer
Product: Irinotecan HCl-trihydraat Fresenius Kabi 20 mg/ml, concentraat voor oplossing voor infusie, Folinezuur Sandoz 10 mg/ml, oplossing voor injectie, Gemcitabine Sandoz 40 mg/ml, concentraat voor oplossing voor infusie, Fluorouracil Accord 50 mg/ml, oplossing voor injectie of infusie, Oxaliplatine Fresenius Kabi 5 mg/ml concentraat voor oplossing voor infusie

Primary endpoint: The main endpoint is overall survival

Source: https://euclinicaltrials.eu/ctis-public/view/2024-516260-29-00